EU clinical trial 2023-503441-55-00: A Phase 3 Randomized Study Comparing Teclistamab in Combination with Daratumumab SC (Tec-Dara) versus Daratumumab SC, Pomalidomide, and Dexamethasone (DPd) or Daratumumab SC, Bortezomib, and Dexamethasone (DVd) in Participants with Relapsed or Refractory Multiple Myeloma
Protocol code: 64007957MMY3001
Sponsor: Janssen - Cilag International (Pharmaceutical company). Phase: Therapeutic exploratory (Phase II). Countries: Netherlands (ongoing, recruitment ended), France (ongoing, recruitment ended), Poland (ongoing, recruitment ended), Spain (ongoing, recruitment ended), Greece (ongoing, recruitment ended), Belgium (ongoing, recruitment ended), Denmark (ongoing, recruitment ended), Germany (ongoing, recruitment ended), Italy (ongoing, recruitment ended), Sweden (ongoing, recruitment ended).
Therapeutic area(s): Diseases [C] - Hemic and Lymphatic Diseases [C15]
Gender: Female, Male. Age: 18-64 years, 65+ years. Enrolment: 310.
Status: Ongoing, recruitment ended. Start date (EU): 2021-10-14. Decision date: 2024-07-16. Results received: No. Last updated: 2026-03-09.
Decision dates by country: SE: 2024-07-22, PL: 2024-07-17, DE: 2024-07-19, BE: 2024-07-19, ES: 2024-07-19, DK: 2024-07-16, NL: 2024-07-16, GR: 2024-09-18, FR: 2024-07-22, IT: 2024-07-22

Condition(s): Relapsed/Refractory Multiple Myeloma
Product: Dexamethasone Tablets BP 2.0mg, Imnovid 3 mg hard capsules, Dexamethason 4 mg JENAPHARM®, teclistamab, teclistamab, Privigen 100 mg/ml solution for infusion, Fortecortin® 2 mg Tabletten, Pomalidomide, Dexamethason 8 mg GALEN® Tabletten, Pomalidomide, Privigen 100 mg/ml solution for infusion, Imnovid 2 mg hard capsules, VELCADE 3.5 mg powder for solution for injection, Pomalidomide, Pomalidomide, Privigen 100 mg/ml solution for infusion, Imnovid 1 mg hard capsules, DARZALEX 1800 mg solution for injection, Imnovid 4 mg hard capsules

Primary endpoint: PFS

Source: https://euclinicaltrials.eu/ctis-public/view/2023-503441-55-00